EU clinical trial 2025-521701-41-00: Darbepoetin in patients candidates for liver transplant: randomized clinical trial (EPO_LT trial)
Protocol code: EPO_LT study
Sponsor: Fundacio De Recerca Clinic Barcelona-Institut D’Investigacions Biomediques August Pi I Sunyer (Laboratory/Research/Testing facility). Phase: Therapeutic use (Phase IV). Countries: Spain (ongoing, recruiting).
Therapeutic area(s): Diseases [C] - Hemic and Lymphatic Diseases [C15]
Gender: Female, Male. Age: 18-64 years, 65+ years. Enrolment: 140.
Status: Ongoing, recruiting. Start date (EU): 2025-11-25. Decision date: 2025-08-13. Results received: No. Last updated: 2025-08-13.

Condition(s): hepatic trasplant
Product: DARBEPOETIN ALFA

Primary endpoint: Difference in the percentage of patients receiving intraoperative (LT) red blood cell transfusions between the intervention group and the control group.
Endpoint(s): Absolute differences from baseline in hemoglobin levels basal and at 4, 8, 12 or 16 weeks after the administration of DP, or at the time of liver transplantation, between the intervention group and the control group., Difference in the percentage of patients receiving intraoperative and during the first 24h after LT, red blood cell transfusions between the intervention group and the control group., Difference in the percentage of patients receiving massive transfusions (>6 units of red blood cells) intraoperatively, between the intervention and control groups., Difference in the 3-month severe postoperative complications assessed by the Comprehensive Charlson Index, between groups., Difference in the overall cost (direct and indirect) of the transplantation, conducting a cost-effective analysis from surgery to three months post-transplant, between groups., To evaluate the difference in the 3 month, 6, and 12 months, postoperative graft survival after liver transplantation, between groups, To evaluate the difference in the 3 month, 6, and 12 months, postoperative patients’ survival after liver transplantation, between groups, Impact of DP treatment on the hemostatic profile of patients with chronic liver disease, comparing the changes in the following coagulation and fibrinolysis markers at basal and 4 weeks after administration: beta TG, PF4, VWF, fibrinogen, TM-TGA, CLT, D dimer, TAT, PAP, hepcidin, erythropoietin, between groups (see Table 1), To explore the impact of anemia on complications of portal hypertension, evaluated by the number and type of acute decompensations (acute gastrointestinal bleeding, infection, encephalopathy, ascites/edemas, renal disfunction) occurred in both groups., To explore the impact of the anemia on the quality of life measured by the EuroQol-5D scale during all visits, in both groups., To explore the predictors of poor response to DP treatment defined as the increase in the hemoglobin level < 1 g/dL after 1 month of treatment., Proportion of patients and severity of treatment-related adverse events during the study period,

Source: https://euclinicaltrials.eu/ctis-public/view/2025-521701-41-00